EU clinical trial 2024-511871-13-00: Strategies for zoledronic acid post-denosumab discontinuation in postmenopausal osteoporosis
Protocol code: RC31/23/0370
Sponsor: Centre Hospitalier Universitaire De Toulouse (Hospital/Clinic/Other health care facility). Phase: Therapeutic use (Phase IV). Countries: France (ongoing, recruiting).
Therapeutic area(s): Diseases [C] - Musculoskeletal Diseases [C05]
Gender: Female. Age: 18-64 years, 65+ years. Enrolment: 200.
Status: Ongoing, recruiting. Start date (EU): 2025-10-02. Decision date: 2024-11-15. Results received: No. Last updated: 2026-06-26.

Condition(s): Postmenopausal osteoporosis
Product: ZOLEDRONIC ACID

Primary endpoint: the proportion of patients who failed: - to maintain lumbar BMD, assessed by dual-energy x-ray absorptiometry (DXA) after 1 year of ZOL. The least significant change in BMD being 0.03 g/cm²; - or presenting an additional vertebral fracture during 1st year.
Endpoint(s): the proportion of patients who failed to maintain hip BMD after 1 year of ZOL (least significant change: 0.03 g/cm²), the changes in hip and lumbar BMD from baseline to 1 year after ZOL, and from year 1 to year 2, the changes from baseline in bone turnover markers (crosslaps, bone alkalin phosphatase, osteocalcin, amino-terminal propeptide of type 1 procollagen, TRAP5b, dickkopf 1, sclerostin), at year 1 and year 2, the number of morphometric vertebral fractures (by vertebral fracture assessment – VFA or X-rays), of clinical vertebral fractures and of clinical peripheral fractures, at year 1 and year 2, the number of adverse events and serious adverse events at year 1 and year 2, the proportion of patients requiring a second ZOL infusion across groups.

Source: https://euclinicaltrials.eu/ctis-public/view/2024-511871-13-00